EU clinical trial 2023-508818-42-00: An International, Multicenter, Randomized, Double-Blind, Parallel Group, Vehicle-Controlled, Phase 2/3 Study with Open-Label Extension Evaluating the Efficacy and Safety of Diacerein 1% Ointment for the Treatment of Generalized Epidermolysis Bullosa Simplex (EBS) [EBShield Study]
Protocol code: AC-203-EBS-007
Sponsor: Twi Biotechnology Inc. (Pharmaceutical company). Phase: Phase II and Phase III (Integrated). Countries: Austria (ongoing, recruiting), Poland (ongoing, recruiting), Italy (ongoing, recruiting), Belgium (ongoing, recruiting), France (ended), Ireland (ongoing, recruiting), Greece (ongoing, recruiting), Spain (ongoing, recruiting).
Therapeutic area(s): Diseases [C] - Skin and Connective Tissue Diseases [C17]
Gender: Female, Male. Age: 0-17 years, 18-64 years. Enrolment: 72.
Start date (EU): 2024-05-21. Decision date: 2024-04-24. Results received: No. Last updated: 2026-04-10.
Decision dates by country: BE: 2024-07-23, IE: 2024-09-06, PL: 2024-04-29, IT: 2024-04-24, FR: 2024-07-31, AT: 2024-04-29, GR: 2024-11-26, ES: 2025-01-07

Condition(s): Generalized Epidermolysis Bullosa Simplex (EBS)
Product: AC-203, Vehicle ointment (Placebo of AC-203 Diacerein 1% Ointment, EU)

Primary endpoint: The primary efficacy endpoint for this study is the proportion of patients achieving treatment success on the IGA of the Treatment Area, in which treatment success is defined as a score of 0 or 1 with at least a 2-point reduction from Baseline A (Visit 2/Day 1) to Week 8 (Visit 5/EOT).
Endpoint(s): Efficacy Endpoints: Change in % BSA of EBS lesion in the Treatment Area from Baseline A (Visit 2/Day 1) to Week 8 (Visit 5/EOT)., Efficacy Endpoints: Change in pain intensity scores from Baseline A (Visit 2/Day 1) to Week 8 (Visit 5/EOT)., Efficacy Endpoints: Change in pruritus intensity scores from Baseline A (Visit 2/Day 1) to Week 8 (Visit 5/EOT)., Efficacy Endpoints: Change in the QOLEB from Baseline A (Visit 2/Day 1) to Week 8 (Visit 5/EOT)., Efficacy Endpoints: Change in EBDASI score (skin activity) from Baseline A (Visit 2/Day 1) to Week 8 (Visit 5/EOT)., Safety Endpoints: Incidence and proportion of patients with AEs, including treatment emergent adverse events (TEAEs), and serious adverse events and relationship to the study medication., Safety Endpoints: Incidence and proportion of patients with mild, moderate, and severe AEs, Safety Endpoints: Change from Baseline A (Visit 2/Day 1) in clinical laboratory results in hematology, biochemistry, and urinalysis. (If the tests are omitted at Baseline A at the discretion of the investigator, the closest data during the screening period can serve as baseline.), Safety Endpoints: Change from Baseline A (Visit 2/Day 1) in vital signs, physical examination, and ECG parameters.(If the tests are omitted at Baseline A at the discretion of the investigator, the closest data during the screening period can serve as baseline.)

Source: https://euclinicaltrials.eu/ctis-public/view/2023-508818-42-00